EU clinical trial 2025-522378-36-00: A Randomised, Placebo-Controlled, Double-Blind, Single-Ascending Dose and Multiple-Ascending Dose First-In-Human Study to Investigate the Safety, Tolerability, Pharmacokinetics, and Pharmacodynamics of Orally Administered ALE1 With or Without Food in Healthy Adult Participants and Adult Patients With Hypophosphatasia
Protocol code: ALE1-101
Sponsor: Alesta Therapeutics B.V. (Pharmaceutical company). Phase: Phase I and Phase II (Integrated)- First administration to humans. Countries: Germany (authorised, recruitment pending).
Therapeutic area(s): Diseases [C] - Congenital, Hereditary, and Neonatal Diseases and Abnormalities [C16]; Diseases [C] - Musculoskeletal Diseases [C05]
Gender: Female, Male. Age: 18-64 years, 65+ years. Enrolment: 24.
Status: Authorised, recruitment pending. Decision date: 2025-11-19. Results received: No. Last updated: 2026-08-04.

Condition(s): Hypophosphatasia
Product: ALE1 matched placebo, ALE1 I, ALE1 III, ALE1

Primary endpoint: Number and severity of treatment emergent adverse events (TEAEs) in healthy participants and patients with hypophosphatasia (HPP) with increasing oral doses of ALE1
Endpoint(s): Pharmacokinetic parameters of single and multiple ascending doses of ALE1., Pharmacodynamic biomarker levels in blood samples of single and multiple ascending doses of ALE1., Dose proportionality in pharmacokinetic parameters in single and multiple ascending doses of ALE1., Effect of food on ALE1 pharmacokinetic parameters.

Source: https://euclinicaltrials.eu/ctis-public/view/2025-522378-36-00